EU clinical trial 2024-514604-14-00: EFFICACY OF ATEZOLIZUMAB CONCURRENT WITH RADIOTHERAPY IN PATIENTS WITH MUSCLE-INVASIVE BLADDER CANCER
Sponsor: Grupo Espanol De Oncologia Genitourinaria-Socug (Patient organisation/association). Phase: Therapeutic exploratory (Phase II). Countries: Spain (ongoing, recruitment ended).
Therapeutic area(s): Diseases [C] - Neoplasms [C04]
Gender: Female, Male. Age: 18-64 years, 65+ years. Enrolment: 39.
Status: Ongoing, recruitment ended. Start date (EU): 2019-09-18. Decision date: 2024-06-11. Results received: No. Last updated: 2026-04-13.

Condition(s): Muscle-invasive bladder cancer
Product: Tecentriq 1 200 mg concentrate for solution for infusion

Primary endpoint: The primary endpoint will be the pathological complete response defined as a response of grade 5 according to Miller and Payne criteria (Appendix 5) after the end of the treatment.

Source: https://euclinicaltrials.eu/ctis-public/view/2024-514604-14-00